EU clinical trial 2024-517275-21-00: "RETINO 2011" : Conservative treatment of patients with retinoblastoma
Protocol code: IC 2011-05
Sponsor: Institut Curie (Hospital/Clinic/Other health care facility). Phase: Therapeutic exploratory (Phase II). Countries: France (ongoing, recruiting).
Therapeutic area(s): Diseases [C] - Eye Diseases [C11]
Gender: Female, Male. Age: 0-17 years. Enrolment: 133.
Status: Ongoing, recruiting. Start date (EU): 2012-02-20. Decision date: 2024-09-05. Results received: No. Last updated: 2024-09-05.

Condition(s): Retinoblastoma
Product: ETOPOSIDE TEVA 20 mg/ml, solution à diluer pour perfusion, CARBOPLATINE TEVA 10 mg/ml, solution pour perfusion, MELPHALAN, VINCRISTINE TEVA 1 mg/ml, solution injectable, ALKERAN 50 mg poudre et solvant pour solution pour perfusion Melphalan

Primary endpoint: For the 3 studies: ocular preservation (absence of secondary enucleation) and absence of external beam radiotherapy at 18 months.
Endpoint(s): Evaluation or the risk of relapse by fundus examination under general anaesthesia until the age of 4 then without general anaesthesia., Prospective evaluation of the ocular and general side effects (short, medium and long term) of the intravenous chemotherapy, intra-arterial chemotherapy, combined to the local treatment as well as the intra-vitreal injections of melphalan., Evaluation of the response to intra-vitreal chemotherapy by melphalan., Study of the radiation doses received during intra-arterial procedures., Evaluate the number of patients presenting with another tumour.

Source: https://euclinicaltrials.eu/ctis-public/view/2024-517275-21-00